EU clinical trial 2023-505933-29-00: Multicenter, open-label, phase II study in patients with immunoglobulin M monoclonal gammopathy of unknown significance and Myelin Associated Glycoprotein antibodies related polyneuropathy and Zanubrutinib Treatment
Protocol code: 22U-0179
Sponsor: University Medical Center Utrecht (Hospital/Clinic/Other health care facility). Phase: Therapeutic exploratory (Phase II). Countries: Netherlands (ongoing, recruiting).
Therapeutic area(s): Diseases [C] - Nervous System Diseases [C10]; Diseases [C] - Hemic and Lymphatic Diseases [C15]
Gender: Female, Male. Age: 18-64 years, 65+ years. Enrolment: 35.
Status: Ongoing, recruiting. Start date (EU): 2024-03-13. Decision date: 2023-10-27. Results received: No. Last updated: 2026-01-13.

Condition(s): IgM monoclonal gammopathy of unknown significance (MGUS) and myelin associated glycoprotein (MAG) antibodies associated polyneuropathy
Product: BRUKINSA 80 mg hard capsules

Primary endpoint: Proportion of patients with ≥2 points improvement on the Inflammatory Neuropathy Cause and Treatment disability score (INCATds) at the end of cycle 12 (1 year from baseline), Incidence of adverse events during treatment and follow up (36 months from baseline), graded by the Common Terminology Criteria for Adverse Events (CTCAE), version 5.0, Dose adjustments made per patient, Registration of drug accountability (counting of remaining capsules after each treatment cycle). Drug accountability will be presented as percentage.
Endpoint(s): Hematological response rate (including progression) at 6, 12, 24 and 36 months, Best achieved hematological response rate during treatment and follow-up, Change from baseline on the Inflammatory Neuropathy Cause and Treatment disability score (INCATds) after 3, 6, 10, 12, 18, 24 and 36 months, at the end of treatment and the end of study, Change from baseline on the Rasch-built Overall Disability Scale for immune-mediated peripheral neuropathies (iRODS) after 3, 6, 10, 12, 18, 24 and 36 months, at the end of treatment and the end of study, Change from baseline on the Overall Neuropathy Limitations Scale (ONLS) after 3, 6, 10, 12, 18, 24 and 36 months, at the end of treatment and the end of study, Change from baseline on the 10 meter walk test after 3, 6, 10, 12, 18, 24 and 36 months, at the end of treatment and the end of study, Change from baseline on the ataxia score after 3, 6, 10, 12, 18, 24 and 36 months, at the end of treatment and the end of study, Change from baseline on the modified Inflammatory Neuropathy Cause And Treatment (INCAT) sensory sum score after 3, 6, 10, 12, 18, 24 and 36 months, at the end of treatment and the end of study, Change from baseline on the grip strength (vigorimetry) after 3, 6, 10, 12, 18, 24 and 36 months, at the end of treatment and the end of study, Registration of hematological progression (and other responses) during treatment and follow-up to assess hematological progression free survival and time to progression, Death registration during treatment and follow up. Overall survival is defined as time from inclusion to death (or end of follow-up), Change from baseline in Bühlmann ELISA titer units, measured after every 2 cycles during treatment and every 6 months during follow-up, Evaluation of molecular markers at diagnosis. Performed using next generation sequencing (NGS) for CXCR4 mutations and the MYD88L265P mutation after CD19 selection of bone marrow aspirate at central laboratory., At baseline, a complete panel of anti-neural antibodies will be performed (only if not done previously), that consists of gangliosides GM1, GM2, GD1a and GD1b., Relation of neurological and hematological response endpoints with molecular markers at diagnosis., Relation of molecular markers with anti-MAG titer, Time to first hematological and first neurological response, Time to maximum hematological and maximum neurological response, Duration of hematological and neurological response during follow up period, Relation of immunological parameters with neurological endpoints, Change from baseline on the quality of life assessment (EQ-5D-5L) measured after 6, 12, 18, 24, 30 and 36 months, at the end of treatment and the end of study, Change from baseline on the patients global impression of change (PGIC) assessment, measured after 6, 12, 18, 24, 30 and 36 months, at the end of treatment and the end of study

Source: https://euclinicaltrials.eu/ctis-public/view/2023-505933-29-00